EU clinical trial 2024-513252-15-00: KILT - A RANDOMIZED NON COMPARATIVE PHASE II STUDY OF LACUTAMAB WITH GEMOX VERSUS GEMOX ALONE IN RELAPSED/REFRACTORY PATIENTS WITH PERIPHERAL T-CELL LYMPHOMA
Protocol code: KILT
Sponsor: LYSARC (Laboratory/Research/Testing facility). Phase: Therapeutic exploratory (Phase II). Countries: Belgium (ongoing, recruitment ended), Spain (ongoing, recruitment ended), Germany (ongoing, recruitment ended), France (ongoing, recruitment ended).
Therapeutic area(s): Diseases [C] - Hemic and Lymphatic Diseases [C15]
Gender: Female, Male. Age: 18-64 years, 65+ years. Enrolment: 56.
Status: Ongoing, recruitment ended. Start date (EU): 2021-01-28. Decision date: 2024-08-09. Results received: No. Last updated: 2026-02-19.
Decision dates by country: BE: 2024-08-12, DE: 2024-08-13, ES: 2024-08-13, FR: 2024-08-09

Condition(s): IN RELAPSED/REFRACTORY PATIENTS WITH PERIPHERAL T-CELL LYMPHOMA
Product: OXALIPLATIN, Lacutamab, GEMCITABINE

Primary endpoint: modified PFS (mPFS), defined as time from randomization until one of the following events occurs, whichever comes first: a) Disease progression (PD) b) Administration of any additional unplanned anti-lymphoma treatment (except allogeneic or autologous hematopoietic cell transplantations (HCT)) c) Relapse after achievement of CR or PR d) Death due to any cause.
Endpoint(s): Response rates according to Lugano classification PET-based, Response rate assessed by Deauville criteria, Duration Of Response (DOR), CR rate and ORR according to Lugano 2014 criteria (PET-based), subgroup analyses of mPFS, ORR, DOR, OS by PTCL subtype based on previous treatment lines, rate of patients proceeding to allogenic stem cell transplantation

Source: https://euclinicaltrials.eu/ctis-public/view/2024-513252-15-00